EU clinical trial 2024-516447-12-00: Early Model-Informed Precision Dosing of beta-lactam antibiotics in critically ill children: big solution for small people?
Protocol code: MOMENTUM trial
Sponsor: Universitair Ziekenhuis Gent (Hospital/Clinic/Other health care facility). Phase: Therapeutic use (Phase IV). Countries: Belgium (ongoing, recruiting).
Therapeutic area(s): Diseases [C] - Bacterial Infections and Mycoses [C01]
Gender: Female, Male. Age: 0-17 years. Enrolment: 58.
Status: Ongoing, recruiting. Start date (EU): 2025-04-30. Decision date: 2024-11-07. Results received: No. Last updated: 2025-03-19.

Condition(s): Systemic infections
Product: AMOXICILLIN, PIPERACILLIN AND BETA-LACTAMASE INHIBITOR, AMOXICILLIN AND BETA-LACTAMASE INHIBITOR, MEROPENEM

Primary endpoint: Proportion of subjects reaching the therapeutic target 100% fT>MIC at 48 hours after start of beta-lactam treatment
Endpoint(s): Proportion of subjects reaching the therapeutic target 100% fT>MIC at 120 hours after start of treatment, Proportion of subjects reaching the therapeutic target 100% fT>MIC within the interval 48 to 72 hours after start of treatment, Hospital length-of-stay

Source: https://euclinicaltrials.eu/ctis-public/view/2024-516447-12-00